EU clinical trial 2025-521600-21-00: A Phase 1/1b Open-Label Dose-Escalation and Dose-Optimization Study of Bcl-2 Inhibitor BGB 21447 in Patients With Mature B Cell Malignancies
Protocol code: BGB-21447-101
Sponsor: Beigene Ltd. (Pharmaceutical company). Phase: Human Pharmacology (Phase I)- First administration to humans. Countries: France (ended), Italy (ended).
Therapeutic area(s): Diseases [C] - Neoplasms [C04]
Gender: Female, Male. Age: 18-64 years, 65+ years. Enrolment: 18.
Status: Ended. End date (EU): 2025-12-19. Decision date: 2025-09-29. Results received: No. Last updated: 2025-09-30.
Decision dates by country: FR: 2025-09-30, IT: 2025-09-29

Condition(s): mature B-Cell malignancies

Source: https://euclinicaltrials.eu/ctis-public/view/2025-521600-21-00